EU clinical trial 2023-503522-40-01: A Phase 2, Randomized, Double-blind, Placebo-controlled Study to Evaluate the Efficacy and Safety of ANB032 in the Treatment of Subjects with Moderate to Severe Atopic Dermatitis
Protocol code: ANB032-201
Sponsor: Anaptysbio Inc. (Pharmaceutical company). Phase: Therapeutic exploratory (Phase II). Countries: Poland (ended), Czechia (ended).
Therapeutic area(s): Diseases [C] - Skin and Connective Tissue Diseases [C17]
Gender: Female, Male. Age: 18-64 years, 65+ years. Enrolment: 84.
Status: Ended. Start date (EU): 2024-04-10. End date (EU): 2024-12-11. End date: 2025-01-07. Decision date: 2024-03-13. Results received: Yes. Last updated: 2024-10-22.
Decision dates by country: PL: 2024-03-13, CZ: 2024-05-31

Condition(s): Atopic Dermatitis
Product: ALCLOMETASONE, HYDROCORTISONE, Placebo solution for injection

Primary endpoint: Proportion of subjects who achieve ≥ 75% reduction (improvement) from Baseline in EASI (EASI-75) at Week 14

Source: https://euclinicaltrials.eu/ctis-public/view/2023-503522-40-01